EU clinical trial 2023-507324-23-00: A Phase 2 Open-label, multicenter study to evaluate efficacy and safety of ZN-c3 in Adult Women with Recurrent or Persistent Uterine Serous Carcinoma
Protocol code: ZN‑c3-004
Sponsor: K-Group Beta Inc. (Pharmaceutical company). Phase: Therapeutic exploratory (Phase II). Countries: Spain (ended), Italy (ended), France (ended).
Therapeutic area(s): Diseases [C] - Neoplasms [C04]
Gender: Female. Age: 18-64 years, 65+ years. Enrolment: 70.
Status: Ended. Start date (EU): 2024-05-22. End date (EU): 2025-10-23. End date: 2025-10-24. Decision date: 2024-03-26. Results received: No. Last updated: 2024-04-11.
Decision dates by country: FR: 2024-03-28, IT: 2024-03-27, ES: 2024-03-26

Condition(s): recurrent or persistent uterine serous carcinoma
Product: APREPITANT, GRANISETRON, DEXAMETHASONE, Akynzeo 300 mg/0.5 mg hard capsules, azenosertib, also known as ZN-c3, ONDANSETRON, azenosertib, also known as ZN-c3, Akynzeo 300 mg/0.5 mg hard capsules, OLANZAPINE

Primary endpoint: Part 1b: • Frequency and severity of TEAEs, including laboratory abnormalities, graded according to the NCI-CTCAE v5.0 • Incidence of dose interruptions, dose reductions, and permanent discontinuations of ZN-c3 due to ZN-c3–related TEAEs, Part 2: • ORR as defined by the revised RECIST v1.1 as assessed by ICR
Endpoint(s): Part 1b •ORR, DOR, PFS, CBR, and TTR as defined by the revised RECIST v1.1. •OS •Plasma PK concentrations of ZN-c3, Part 2 •DOR as defined by RECIST v1.1. and assessed by ICR •PFS, CBR, and TTR as defined by RECIST v1.1. and assessed by ICR •ORR, PFS, CBR, and TTR as defined by RECIST v1.1. and assessed by the Investigator •OS •Frequency and severity of TEAEs •Association of key biomarkers with clinical outcome of ZN-c3 activity •Plasma PK concentrations of ZN-c3

Source: https://euclinicaltrials.eu/ctis-public/view/2023-507324-23-00